EU clinical trial 2025-522261-30-00: Evaluation of long-term safety in parkinsonian patients with intracerebroventricular administration of A-dopamine (anaerobic dopamine) - (DIVE-Follow up)
Protocol code: 2025_0243
Sponsor: Centre Hospitalier Universitaire De Lille (Hospital/Clinic/Other health care facility). Phase: Phase I and Phase II (Integrated)- First administration to humans. Countries: France (authorised, recruiting).
Therapeutic area(s): Diseases [C] - Nervous System Diseases [C10]
Gender: Female, Male. Age: 18-64 years, 65+ years. Enrolment: 2.
Status: Authorised, recruiting. Start date (EU): 2025-10-01. Decision date: 2025-08-20. Results received: No. Last updated: 2025-08-20.

Condition(s): Parkinson disease

Source: https://euclinicaltrials.eu/ctis-public/view/2025-522261-30-00